EU clinical trial 2024-512887-77-00: Cross-institutional, prospective, open label, single group basket study of combined CRAF and MEK inhibition in advanced-stage malignancies harboring BRAF mutations with impaired kinase activity - SORATRAM
Protocol code: 1056 SORATRAM
Sponsor: Medical Center - University Of Freiburg (Hospital/Clinic/Other health care facility). Phase: Phase I and Phase II (Integrated)- Other. Countries: Germany (ongoing, recruitment ended).
Therapeutic area(s): Diseases [C] - Neoplasms [C04]
Gender: Female, Male. Age: 18-64 years, 65+ years. Enrolment: 30.
Status: Ongoing, recruitment ended. Start date (EU): 2020-10-21. Decision date: 2024-10-07. Results received: No. Last updated: 2025-12-18.

Condition(s): advanced-stage malignancies harboring BRAF mutations with impaired kinase activity
Product: Nexavar 200 mg film-coated tablets, Mekinist 0.5 mg film-coated tablets, SORAFENIB

Primary endpoint: MTD of trametinib given in combination with sorafenib
Endpoint(s): Secondary endpoints: • Adverse (AEs), serious adverse events (SAEs) • Disease control rate (SD, PR or CR according to RECIST 1.1), best response during trial treatment) • Overall response rate (CR or PR according to RECIST 1.1) at the end of cycle 4 and cycle 7 • Overall survival from start of trial treatment • Translational parameter Exploratory endpoints: • Progression free survival ratio (PFSr)

Source: https://euclinicaltrials.eu/ctis-public/view/2024-512887-77-00